EU clinical trial 2024-519976-19-00: The IMAGINE study: A phase 3b open label, single arm study to assess the effect of depemokimab on airway structure and function in asthma with Type 2 inflammation characterized by an eosinophilic phenotype utilizing quantitative high-resolution CT and bronchoscopic airway sampling in a sub study
Protocol code: 223529
Sponsor: Glaxosmithkline Research & Development Limited (Pharmaceutical company). Phase: Therapeutic confirmatory (Phase III). Countries: Belgium (ongoing, recruiting), Spain (ongoing, recruiting), Italy (ongoing, recruiting), Greece (ongoing, recruiting), France (ongoing, recruiting), Germany (ongoing, recruiting).
Therapeutic area(s): Diseases [C] - Respiratory Tract Diseases [C08]
Gender: Female, Male. Age: 18-64 years, 65+ years. Enrolment: 55.
Status: Ongoing, recruiting. Start date (EU): 2025-11-26. Decision date: 2025-10-20. Results received: No. Last updated: 2026-05-26.
Decision dates by country: DE: 2025-10-22, GR: 2025-10-20, BE: 2025-10-20, ES: 2025-10-27, FR: 2025-10-20, IT: 2025-10-21

Condition(s): Asthma with type 2 inflammation characterized by an eosinophilic phenotype

Primary endpoint: Change from baseline in total mucus plug volume measured at TLC at Week 26
Endpoint(s): Change from baseline in airway wall thickness measured at TLC at Week 52.

Source: https://euclinicaltrials.eu/ctis-public/view/2024-519976-19-00